EU clinical trial 2023-506039-13-00: A PHASE 3, RANDOMIZED, DOUBLE-BLIND, PLACEBO-CONTROLLED STUDY TO EVALUATE THE EFFICACY AND SAFETY OF INTRAVENOUS EFZOFITIMOD IN PATIENTS WITH PULMONARY SARCOIDOSIS
Protocol code: ATYR1923-C-004
Sponsor: aTYR Pharma Inc. (Pharmaceutical company). Phase: Therapeutic confirmatory (Phase III). Countries: France (ended), Netherlands (ended), Spain (ended), Italy (ended), Germany (ended).
Therapeutic area(s): Diseases [C] - Immune System Diseases [C20]
Gender: Female, Male. Age: 18-64 years, 65+ years. Enrolment: 101.
Status: Ended. Start date (EU): 2023-04-12. End date (EU): 2025-07-10. End date: 2025-07-14. Decision date: 2023-07-10. Results received: No. Last updated: 2025-09-09.
Decision dates by country: DE: 2023-12-08, ES: 2023-07-10, IT: 2023-08-14, FR: 2023-07-18, NL: 2023-07-11

Condition(s): pulmonary sarcoidosis
Product: Efzofitimod

Primary endpoint: Change from baseline in mean daily OCS dose at Week 48
Endpoint(s): 1. Steroid-free rate at Week 48, 2. Steroid-free and stable KSQ-Lung composite rate at Week 48, 3. Change from baseline in absolute value of FVC at Week 48

Source: https://euclinicaltrials.eu/ctis-public/view/2023-506039-13-00